EU clinical trial 2024-515913-17-00: SPI-62 as a Treatment for Adrenocorticotropic Hormone- dependent Cushing’s Syndrome
Protocol code: SPI-62-CL-2001
Sponsor: Sparrow Pharmaceuticals Inc. (Pharmaceutical company). Phase: Therapeutic exploratory (Phase II). Countries: Bulgaria (ended), Romania (ended).
Therapeutic area(s): Diseases [C] - Hormonal diseases [C19]
Gender: Female, Male. Age: 18-64 years. Enrolment: 9.
Status: Ended. Start date (EU): 2024-10-10. End date (EU): 2025-09-01. Decision date: 2024-10-01. Results received: No. Last updated: 2025-02-03.
Decision dates by country: BG: 2024-10-01, RO: 2024-10-15

Condition(s): Cushing's Syndrome
Product: SPI-62_DF2

Primary endpoint: The urinary HSD-1 ratio ([tetrahydrocortisol + allotetrahydrocortisol]/tetrahydrocortisone) at Week 6 in subjects with Cushing's disease.
Endpoint(s): 1. Adverse events, including clinically significant abnormal values on clinical laboratory evaluations (clinical chemistry, hematology, and urinalysis), continuous glucose monitoring (CGM), 12-lead ECGs, vital signs measurements (including orthostatic vital sign measurements), physical examinations, and clinically significant changes from baseline, for HPA and HPG axis biomarkers (ACTH, serum cortisol, free cortisol, cortisone, arginine vasopressin [AVP], testosterone, estradiol, dehydroepiandro, 2. Clinical laboratory evaluations, ECG intervals, pulse, temperature, and HPA and HPG axis biomarkers at Week 6, as well as changes from baseline during 12 weeks of SPI-62 administration, will be described., 3. Long-term safety, including assessments of longer-term will be monitored in the open-label extension phase of this trial., 4. Glucose AUC during oral glucose tolerance test (OGTT) and OGTTCGM, other CGM parameters (e.g., CGM time > 140 and > 200 mg/dL, among others), HbA1c, insulin, fasting plasma glucose, body weight, body mass index, dual energy x-ray absorptiometry (DEXA) scan results (body fat and muscle content [including total body, trunk, abdominal, head/neck, supraclavicular and hepatic fat content], bone-mineral density [T- and Zscores] and trabecular bone score), bone markers [osteocalcin, procollagen I N-, 5. Performance on muscle strength (Timed Up and Go-Chair Stand [TUGCS], hand grip strength [HGS] tests), and scores on Symptoms of Major Depressive Disorder Scale (SMDDS), Short Form Survey-36 version 2 (SF-36v2), Medical Outcomes Study Sleep Scale-Revised (MOS-Sleep-R), pain numeric rating scale (NRS), and Patient Global Impression of Severity(PGI-S)/Patient Global Impression of Change (PGI-C) at Week 6, as well as change from baseline during 6 and 12 weeks of SPI-62 administration, will be des, 6. Proportions of subjects with urinary HSD-1 ratio ≤ 0.7 and ≤ 0.2 at Week 6 will be reported., 7. Change from baseline during 6 and 12 weeks of SPI-62 administration on urinary HSD-1 ratio will be described., 8. 24-hour UFC and steroid profile, and spot urine for the urinary ratio cortisone/cortisol at Week 6, as well as change from baseline during 6 and 12 weeks of SPI-62 administration, will be described., 9. Changes in Cushing's phenotypic features will be tabulated (Appendix 7) and monitored into the long-term extension trial (except for photography)., 10. The predictive value of urinary HSD-1 ratio at Week 6 for clinical efficacy endpoints will be described., 11. Efficacy analyses will be reported for all evaluable subjects (ITT population), per-protocol subjects and for the subset of evaluable and per-protocol subjects with Cushing's disease.

Source: https://euclinicaltrials.eu/ctis-public/view/2024-515913-17-00